EU clinical trial 2024-510766-16-00: (SPARROW) Standard versus Pre-emptive Antibiotic Treatment to Reduce the Rate of Infectious Outcomes after Whipple’s procedure (SPARROW): a multicenter, randomized controlled trial
Protocol code: NL82304.058.22
Sponsor: Academisch Ziekenhuis Leiden (Hospital/Clinic/Other health care facility). Phase: Phase III and phase IV (Integrated). Countries: Netherlands (ongoing, recruiting).
Therapeutic area(s): Diseases [C] - Neoplasms [C04]; Diseases [C] - Digestive System Diseases [C06]
Gender: Female, Male. Age: 18-64 years, 65+ years. Enrolment: 458.
Status: Ongoing, recruiting. Start date (EU): 2023-03-06. Decision date: 2024-06-10. Results received: No. Last updated: 2025-08-08.

Condition(s): Pancreatoduodenectomy with a high risk for contaminated bile
Product: Metronidazol 5 mg/ml Fresenius, infusievloeistof, Cefuroxim Hikma 1500 mg poeder voor oplossing voor injectie of infusie

Primary endpoint: To evaluate the additional value of pre-emptive antibiotic prophylaxis on clinically relevant OSIs in patients undergoing pancreatoduodenectomy with a high risk for contaminated bile (patients with preoperative biliary drainage or an ampullary malignancy).
Endpoint(s): Rate of OSIs according to the CDC definition, Rate of isolated OSIs (OSIs without concurrent anastomotic leak), Rate of superficial SSIs (wound infections), Rate of clinically relevant POPF, Rate of bile and enteric leak, Rate of post pancreatectomy hemorrhage, Rate of delayed gastric emptying, Rate of postoperative bacteraemia, Rate of Clostridium difficile infection, Rate of major complications (Clavien-Dindo ≥III), Reintervention (either surgical, radiological of endoscopic), ICU admission, Length of hospital stay, Readmission, Mortality, Switch of postoperative antibiotics, Antibiotic sensitivity patterns in bile cultures and cultures from surgical sites, Concordance of microorganisms in bile and surgical site cultures, Rate of chyle leak according to the ISGPS definition.

Source: https://euclinicaltrials.eu/ctis-public/view/2024-510766-16-00